EU clinical trial 2023-506928-83-00: Investigation of Safety, Tolerability, Pharmacokinetics and Pharmacodynamics of Single Subcutaneous Injections of NNC0582-0001 in Healthy Adults
Protocol code: NN6582-4838
Sponsor: Novo Nordisk A/S (Pharmaceutical company). Phase: Human Pharmacology (Phase I)- First administration to humans. Countries: Austria (ended).
Therapeutic area(s): Not possible to specify
Gender: Female, Male. Age: 18-64 years. Enrolment: 56.
Status: Ended. Start date (EU): 2022-11-12. End date (EU): 2025-10-16. Decision date: 2024-06-17. Results received: No. Last updated: 2025-01-20.

Condition(s): Healthy Volunteers

Source: https://euclinicaltrials.eu/ctis-public/view/2023-506928-83-00